EU clinical trial 2023-504794-20-00: A phase I randomized, investigator and participant-blind, adaptive, multiple-ascending dose, parallel and four-way crossover, placebo-controlled study to investigate the safety, tolerability, pharmacokinetics, pharmacodynamics, and drug interactions (with midazolam) of RO7308480 following oral administration in healthy participants.
Protocol code: BP43804
Sponsor: F. Hoffmann-La Roche AG (Pharmaceutical company). Phase: Human Pharmacology (Phase I)- Other. Countries: France (ended).
Therapeutic area(s): Psychiatry and Psychology [F] - Behavioral Disciplines and Activities [F04]
Gender: Female, Male. Age: 18-64 years. Enrolment: 100.
Status: Ended. Start date (EU): 2023-10-26. End date (EU): 2024-07-17. Decision date: 2023-10-23. Results received: No. Last updated: 2024-05-28.

Condition(s): Healthy participants (part 1 and part 2)

Source: https://euclinicaltrials.eu/ctis-public/view/2023-504794-20-00